EU clinical trial 2023-509711-83-00: A Phase 3, Randomized, Open-Label Study of Nivolumab Combined with Cabozantinib versus Sunitinib in Participants with Previously Untreated, Advanced or Metastatic Renal Cell Carcinoma
Protocol code: CA209-9ER
Sponsor: Bristol-Myers Squibb Services Unlimited Company (Pharmaceutical company). Phase: Therapeutic confirmatory (Phase III). Countries: Poland (ended), Spain (ended), Czechia (ended), Italy (ended), Greece (ended), Romania (ended), Germany (ended).
Therapeutic area(s): Diseases [C] - Neoplasms [C04]
Gender: Female, Male. Age: 18-64 years, 65+ years. Enrolment: 265.
Status: Ended. Start date (EU): 2017-10-27. End date (EU): 2026-04-01. End date: 2026-04-02. Decision date: 2024-04-10. Results received: No. Last updated: 2026-05-14.
Decision dates by country: CZ: 2024-04-11, DE: 2024-04-15, RO: 2024-04-17, GR: 2024-05-21, ES: 2024-04-10, PL: 2024-04-12, IT: 2024-05-03

Condition(s): Advanced or Metastatic Renal Cell Carcinoma
Product: Ipilimumab, OPDIVO 10 mg/mL concentrate for solution for infusion., CABOMETYX 20 mg film-coated tablets, Ipilimumab, Sutent 12.5 mg hard capsules, Sutent 12.5 mg hard capsules

Primary endpoint: Progression Free Survival (PFS) per blinded independent central review (BICR) of Arm A versus Arm C in all randomized participants
Endpoint(s): Overall Survival (OS) of Arm A versus Arm C, Objective Response Rate (ORR), Incidence of adverse events (AEs), Incidence of Serious Adverse Events (SAEs)

Source: https://euclinicaltrials.eu/ctis-public/view/2023-509711-83-00